EU clinical trial 2024-519666-43-00: A randomised, open label, single dose, two periods, crossover study of the comparative pharmacokinetics of two alendronic acid formulations in healthy volunteers under fasted conditions: a pilot study.
Protocol code: ALIQ-0124/PKP
Sponsor: Faes Farma S.A. (Pharmaceutical company). Phase: Human Pharmacology (Phase I)- Other. Countries: Czechia (ended).
Therapeutic area(s): Diseases [C] - Musculoskeletal Diseases [C05]
Gender: Female, Male. Age: 18-64 years. Enrolment: 18.
Status: Ended. Start date (EU): 2025-03-04. End date (EU): 2025-03-26. Decision date: 2025-02-05. Results received: No. Last updated: 2025-02-05.

Condition(s): not applicable (submitted trial is a pharmacokinetic study in healthy subjects)

Source: https://euclinicaltrials.eu/ctis-public/view/2024-519666-43-00